EU clinical trial 2024-514408-15-00: Two initial faricimab loading doses in treatment-naive neovascular AMD
Sponsor: Medical University Of Graz (Educational Institution). Phase: Therapeutic use (Phase IV). Countries: Austria (ended).
Therapeutic area(s): Diseases [C] - Eye Diseases [C11]
Gender: Female, Male. Age: 18-64 years, 65+ years. Enrolment: 50.
Status: Ended. Start date (EU): 2024-11-14. End date (EU): 2026-03-11. Decision date: 2024-10-14. Results received: No. Last updated: 2024-10-14.

Condition(s): Neovascular age-related macular degeneration
Product: Vabysmo 120 mg/mL solution for injection

Primary endpoint: Proportion of patients without disease activity at week 8.
Endpoint(s): Proportion of patients with a 4, 6, 8, 10, 12, 14 or 16 week treatment interval between the 2nd faricimab loading dose and the 3rd faricimab injection., Change in best corrected visual acuity from baseline to week 4 and 8., Change in central subfield thickness from baseline to week 4 and 8., Characteristics/measurements (in optical coherence tomography (OCT), optical coherence tomography angiography (OCTA), angiography and best corrected visual acuity (BCVA) assessment), which can predict active/non-active disease.

Source: https://euclinicaltrials.eu/ctis-public/view/2024-514408-15-00